EU clinical trial 2024-517686-17-01: Filling bone erosions: a longitudinal multicentric HR-pQCT study of subcutaneous tocilizumab in rheumatoid arthritis
Protocol code: CHRO-2014-03
Sponsor: Centre Hospitalier Universitaire D Orleans (Hospital/Clinic/Other health care facility). Phase: Therapeutic use (Phase IV). Countries: France (ongoing, recruitment ended).
Therapeutic area(s): Diseases [C] - Musculoskeletal Diseases [C05]
Gender: Female, Male. Age: 18-64 years, 65+ years. Enrolment: 60.
Status: Ongoing, recruitment ended. Start date (EU): 2016-06-30. Decision date: 2025-01-02. Results received: No. Last updated: 2025-01-02.

Condition(s): rheumatoid arthritis
Product: RoActemra 162 mg solution for injection in pre-filled syringe.

Primary endpoint: Bone erosion change of width, depth and volume measured by HRpQCT after 12 months of subcutaneous tocilizumab
Endpoint(s): Number of participants with associated factors with erosion changes by HRpQCT (Associated therapeutic, clinical and biological response )ultrasound ...), Changes of Bone mineral density by DXA at the lumbar spine and proximal femur, Correlation Between clinical activity measured by various indices (Disease Activity Score 28, Clinical Disease Activity Iindex , Simplify Disease Activity Index , American College of Rheumatology - European League against Rheumatism: ACR EULAR) and ultrasound data., Changes of bone microarchitecture by tibia HRpQCT

Source: https://euclinicaltrials.eu/ctis-public/view/2024-517686-17-01